EU clinical trial 2024-517709-10-00: A randomized trial of tacrolimus monotherapy compared to standard triple immune suppressive medication in elderly recipients of a kidney transplant to reduce infection-related mortality and improve quality of life; the TACMONO-XL study.
Sponsor: Erasmus Universitair Medisch Centrum Rotterdam (Erasmus MC) (Hospital/Clinic/Other health care facility). Phase: Therapeutic use (Phase IV). Countries: Netherlands (ongoing, recruiting).
Therapeutic area(s): Not possible to specify
Gender: Female, Male. Age: 18-64 years, 65+ years. Enrolment: 304.
Status: Ongoing, recruiting. Start date (EU): 2025-08-04. Decision date: 2025-06-06. Results received: No. Last updated: 2025-06-06.

Condition(s): kidney transplantation
Product: PREDNISONE, MYCOPHENOLATE MOFETIL, TACROLIMUS

Primary endpoint: - death by infectious disease - infectious burden defined as the number of infections requiring hospitalization and/or proven viral infections including cytomegalovirus and BK-virus replication within a follow-up of 3 years.
Endpoint(s): - quality of life - biopsy-proven rejection from time of randomization to end of follow-up at 3 years post-transplantation. - Assessment of de novo alloantibody formation as detected by a Luminex-based assay (6 months, 1,2 and 3 years after transplantation) - Assessment of the circulating alloreactive T cells in time (before, 1, 2 and 3 years after transplantation) - Graft function measured by eGFR and 24-hr urine collection - Patient and graft survival

Source: https://euclinicaltrials.eu/ctis-public/view/2024-517709-10-00